EU clinical trial 2024-516433-13-00: LONG-TERM EFFECTIVENESS AND SAFETY EVALUATION OF OCRELIZUMAB IN FRENCH PATIENTS WITH PROGRESSIVE MS: CONSONANCE EXTENSION STUDY
Protocol code: 21-PP-23
Sponsor: Centre Hospitalier Universitaire De Nice (Hospital/Clinic/Other health care facility). Phase: Therapeutic confirmatory (Phase III). Countries: France (ongoing, recruiting).
Therapeutic area(s): Diseases [C] - Nervous System Diseases [C10]
Gender: Female, Male. Age: 18-64 years. Enrolment: 89.
Status: Ongoing, recruiting. Start date (EU): 2024-09-19. Decision date: 2024-09-19. Results received: No. Last updated: 2025-10-02.

Condition(s): Progressive multiple sclerosis

Source: https://euclinicaltrials.eu/ctis-public/view/2024-516433-13-00